EU clinical trial 2024-515022-88-00: A Phase 3, Multicenter, Randomized, Parallel-Group, Double-Masked, 2-Arm, Sham Controlled Study of the Efficacy, Safety, and Tolerability of ANX007 (Vonaprument) Administered by Intravitreal Injection in Participants with Dry Age-Related Macular Degeneration with Geographic Atrophy
Protocol code: ANX007-GA-02
Sponsor: Annexon Inc. (Pharmaceutical company). Phase: Therapeutic confirmatory (Phase III). Countries: Italy (ongoing, recruitment ended), France (ongoing, recruitment ended), Poland (ongoing, recruitment ended), Germany (ongoing, recruitment ended), Hungary (ongoing, recruitment ended), Spain (ongoing, recruitment ended), Netherlands (ongoing, recruitment ended), Czechia (ongoing, recruitment ended), Austria (ongoing, recruitment ended).
Therapeutic area(s): Diseases [C] - Eye Diseases [C11]
Gender: Female, Male. Age: 18-64 years, 65+ years. Enrolment: 125.
Status: Ongoing, recruitment ended. Start date (EU): 2025-03-03. Decision date: 2025-02-10. Results received: No. Last updated: 2026-04-07.
Decision dates by country: NL: 2025-02-10, PL: 2025-02-17, HU: 2025-02-13, FR: 2025-03-31, AT: 2025-02-17, IT: 2025-02-12, CZ: 2025-02-12, ES: 2025-02-11, DE: 2025-04-14

Condition(s): Dry Age-Related Macular Degeneration (AMD) with geographic atrophy (GA)
Product: ANX007

Primary endpoint: Confirmed best corrected visual acuity (BCVA) ≥15-letter loss from baseline through Month 15 as assessed by the Early Treatment Diabetic Retinopathy Study (ETDRS) method.
Endpoint(s): Incidence and severity of ocular and systemic treatment-emergent adverse events (TEAEs) and adverse events of special interest (AESI)

Source: https://euclinicaltrials.eu/ctis-public/view/2024-515022-88-00